EU clinical trial 2023-509341-12-00: AN OPEN LABEL, RANDOMISED, CONTROLLED CLINICAL TRIAL TO ASSESS THE SAFETY OF ENDOBRONCHIAL ADMINISTRATION OF ALLOGENEIC MESENCHYMAL STROMAL CELLS IN PATIENTS WITH LUNG TRANSPLANT CHRONIC REJECTION: Study ENDOSC-CLAD
Sponsor: Fundacion Para La Investigacion Biomedica Del Hospital Universitario Puerta De Hierro Majadahonda (Patient organisation/association). Phase: Therapeutic exploratory (Phase II). Countries: Spain (ongoing, recruiting).
Therapeutic area(s): Diseases [C] - Respiratory Tract Diseases [C08]
Gender: Female, Male. Age: 18-64 years. Enrolment: 12.
Status: Ongoing, recruiting. Start date (EU): 2023-02-22. Decision date: 2024-11-14. Results received: No. Last updated: 2026-01-23.

Condition(s): Patients with lung transplant, either unilateral or bilateral and an established diagnosis of BOS ≧ 0p (FEV1≤ 90% and / or FEF 25-75% ≤ of the baseline value with no other justifying cause) in the last 6 months.
Product: PDH-MSC-TxP

Primary endpoint: Incidence of early onset (24h) adverse events following MSCs administration: desaturation, hypotension, radiological infiltrates, fever or changes in oxygen therapy requirements., Incidence of adverse events of special interest since randomization: lower respiratory tract infections, acute rejection (as defined by the presence of A1-A4 o B1R, B2R in biopsy), BO worsening (as measured by >10% decline in FEV1 from baseline).
Endpoint(s): Mean changes in FEV1 at 12-month from baseline., Proportion of patients with >10% decrease in FEV1 from baseline., Time to a >10% decrease in FEV1 from baseline., Proportion of patients progressing to grade 3 BO (as defined by a FEV1 below 50% from best value post-transplant)., Mean changes in FVC from baseline to 12-month, All-cause mortality rate, Re-transplant or CLAD-related mortality rate., Rate of acute rejection (as defined by the presence of A1-A4 o B1R, B2R in biopsy) at any time during the 12-month follow up period., Incidence of presence of specific antibodies against donor HLA., CLAD progression, as defined by > 10% decline in FEV1 in two consecutive time-points, Mean changes in the mMRC Scale at 12-month., Total hospitalization days during 12-month follow-up period., Proportion of patients requiring ambulatory oxygen therapy.

Source: https://euclinicaltrials.eu/ctis-public/view/2023-509341-12-00